EU clinical trial 2023-506656-24-00: Immediate corticosteroid therapy and rituximab to prevent generalization in ocular myasthenia gravis: a PROBE-type multicenter, open-label, randomized controlled trial
Sponsor: Hopital Fondation Adolphe De Rothschild (Hospital/Clinic/Other health care facility). Phase: Therapeutic confirmatory (Phase III). Countries: France (ongoing, recruiting).
Therapeutic area(s): Diseases [C] - Immune System Diseases [C20]
Gender: Female, Male. Age: 18-64 years, 65+ years. Enrolment: 128.
Status: Ongoing, recruiting. Start date (EU): 2025-02-12. Decision date: 2024-03-21. Results received: No. Last updated: 2025-06-06.

Condition(s): Myasthenia gravis
Product: SOLUMEDROL 40 mg, poudre pour solution injectable, POLARAMINE 5 mg/1 ml, solution injectable, IMUREL 50 mg, comprimé pelliculé, CORTANCYL 20 mg, comprimé sécable, PARACETAMOL PANPHARMA 10 mg/ml, solution pour perfusion, Ruxience 500 mg concentrate for solution for infusion

Primary endpoint: Comparison of the proportion of patients who progressed to generalized myasthenia within 2 years of follow-up between the standardized experimental group and the control group. Generalization is defined by a loss of 5 points or more on any Myasthenic Muscle Score (MMS) item, excluding "eyelid occlusion" and "extrinsic ocular musculature".
Endpoint(s): Comparison of the proportion of patients who progressed to generalized myasthenia gravis in the first year of follow-up between the standardized experimental group and the control group. Generalization is defined as for the primary endpoint., Comparison between the standardized experimental group and the control group of the severity of generalization symptoms according to: a. Myasthenic Muscle Score (MMS), b. Myasthenia Gravis Composite Scale (MGC), c. MG Activities of Daily Living (MG-ADL) score., Comparison between standardized experimental group and control group of number of hospitalizations and ICU admissions due to myasthenia exacerbation or adverse event, Comparison of the proportion of patients treated with Ig-IV or plasma exchange between the standardized experimental group and the control group., Comparison between the standardized experimental group and the control group of the proportion of patients achieving remission of ocular symptoms, as defined by the first three items of the MGC equal to zero, Comparison between the standardized experimental group and the control group of the proportion of patients presenting an ocular relapse, defined by a loss of 5 points or more on the sub-score comprising the 2 ocular items (diplopia and ptosis) of the MMS, without generalization of symptoms., Comparison between standardized experimental group and control group of quality of life measured by: a. Myasthenia gravis quality of life score (MG-QoL15), b. National Eye Institute Visual Functioning Questionnaire with neuro-ophthalmological supplement (NEI VFQ 25 + supplement), Comparison between standardized experimental group and control group, of cumulative dose of prednisone equivalent prescribed, Comparison between the standardized experimental group and the control group of changes in the following clinical scores: MMS, MGC, MG-ADL, MGFA-PIS.

Source: https://euclinicaltrials.eu/ctis-public/view/2023-506656-24-00